EU clinical trial 2023-503859-10-00: A MULTICENTER, RANDOMIZED, PARALLEL-GROUP, DOUBLE-BLIND, ACTIVE-CONTROLLED STUDY TO EVALUATE THE EFFICACY AND SAFETY OF BIMEKIZUMAB COMPARED TO USTEKINUMAB IN CHILDREN AND ADOLESCENT FROM 6 YEARS TO LESS THAN 18 YEARS OF AGE WITH MODERATE TO SEVERE PLAQUE PSORIASIS
Protocol code: PS0021
Sponsor: UCB Biopharma (Pharmaceutical company). Phase: Therapeutic confirmatory (Phase III). Countries: Germany (ongoing, recruitment ended), Belgium (ongoing, recruitment ended), Czechia (ongoing, recruitment ended), Spain (ongoing, recruitment ended), Italy (ongoing, recruitment ended), France (ended), Hungary (ongoing, recruitment ended), Poland (ongoing, recruitment ended).
Therapeutic area(s): Diseases [C] - Immune System Diseases [C20]
Gender: Female, Male. Age: 0-17 years. Enrolment: 122.
Start date (EU): 2024-08-12. Decision date: 2024-07-15. Results received: No. Last updated: 2026-02-27.
Decision dates by country: CZ: 2024-07-17, FR: 2024-07-15, HU: 2024-07-17, ES: 2024-07-16, IT: 2024-09-13, BE: 2024-07-22, PL: 2024-07-22, DE: 2024-07-17

Condition(s): Moderate to Severe Plaque Psoriasis
Product: Placebo matching test and comparator. 0.9% sodium chloride solution for injection (unauthorized), ustekinumab, Placebo matching test and comparator. 0.9% sodium chloride solution for injection (authorized - MA number: 6697366.00.00), bimekizumab

Primary endpoint: Psoriasis Area Severity Index 90 (PASI90) response at Week 16, Investigator´s Global Assessment (IGA) 0/1 response at Week 16
Endpoint(s): PASI75 response at Week 4, PASI100 response at Week 16, PASI90 response at Week 48, IGA 0/1 response at Week 48, PASI100 response at Week 48, IGA 0 response at Week 16, IGA 0 response at Week 48, Treatment-emergent adverse events (TEAE)s, Serious TEAEs, TEAEs leading to discontinuation of investigational medicinal product (IMP), TEAEs leading to withdrawal from the study, Selected safety topics of interest (including infection [serious, opportunistic, fungal, and tuberculosis (TB)], inflammatory bowel disease (IBD), and injection site reactions) with onset occurring from day of first dose through 20 weeks after final dose of IMP adjusted by duration of study participant exposure to IMP, Change from Baseline in vital signs, Change from Baseline in physical examination findings, Change from Baseline in height (growth assessment), Change from Baseline in weight (growth assessment), Change from Baseline in laboratory analyses (chemistry and hematology), Change from Baseline in Children’s Dermatology Life Quality Index (CDLQI) total score at Week 16, Change from Baseline in CDLQI total score at Week 48, Change from Baseline in Childhood Health Assessment Questionnaire (CHAQ) disability index at Week 16 for study participants with juvenile psoriatic arthritis (PsA) prior to Baseline, Change from Baseline in Peak Pruritus numerical rating scale (NRS) score at Week 16, Plasma bimekizumab concentrations prior to and following IMP administration over the Initial Treatment Period, over the Maintenance Period, and over the OLE Period, Plasma anti-bimekizumab antibodies prior to and following IMP administration over the Initial Treatment Period, over the Maintenance Period, and over the OLE Period

Source: https://euclinicaltrials.eu/ctis-public/view/2023-503859-10-00